EU clinical trial 2024-518877-33-00: An open-label phase II prospective clinical trial to investigate safety, tolerability, maximum tolerated dose and anti-tumor effect for SCO-101 in combination with FOLFIRI as a safe and efficient treatment modality in metastatic or advanced colorectal cancer (mCRC) patients with acquired FOLFIRI resistant cancer disease
Protocol code: SCO101-001
Sponsor: Scandion Oncology A/S (Pharmaceutical company). Phase: Therapeutic exploratory (Phase II). Countries: Spain (ended).
Therapeutic area(s): Diseases [C] - Digestive System Diseases [C06]
Gender: Female, Male. Age: 18-64 years, 65+ years. Enrolment: 31.
Status: Ended. Start date (EU): 2022-03-17. End date (EU): 2025-02-26. Decision date: 2024-11-19. Results received: Yes. Last updated: 2024-11-19.

Condition(s): Metastatic Colorectal Cancer
Product: Fluorouracil Injection 25 mg/ml, solution for injection, Oncofolic 50 mg/ml, Injektions-/Infusionslösung, Irinotecan Hydrochloride 20 mg/mL concentrate for solution for infusion

Primary endpoint: Safety and tolerability by assessing the number, frequency, and severity of adverse events (AEs) collected from the time of first treatment until four weeks after last administration of study treatment to evaluate safety of SCO-101 in combination with FOLFIRI determined according to CTCAE version 5.0., Stage 1 and 3: Maximum tolerated dose (MTD) by evaluation of dose-limiting toxicities (DLTs) of SCO-101 in combination with FOLFIRI., Stages 2: ORR defined as Complete Response (CR) and Partial Response (PR) using the RECIST v. 1.1 after 20 weeks from treatment start.
Endpoint(s): Progression free survival (PFS) defined as time in months from the date of first study treatment to the date of disease progression or death from any cause, whichever comes first., Duration of response (DOR) (from first response to progression)., DOR after administration of SCO-101 compared to DOR from patients’ initial FOLFIRI treatment regimen (i.e., without SCO-101)., Overall survival (OS) defined as time in months from the date of first study treatment to the date of death., ORR defined as CR and PR using the RECIST v. 1.1 for the entire treatment period., Clinical benefit rate (CBR) defined as the number of patients obtaining CR, PR, or SD ≥ 16 weeks according to RECIST v.1.1., Pharmacokinetic profile of SCO-101, Irinotecan, SN-38, SN-38-glucuronide and 5-FU will be determined by means of: Time to maximum drug plasma concentration (tmax), Half-life (T½), Volume of Distribution (Vd/F), Clearance (CL/F), Area Under the plasma drug Concentration-time curve (AUC) and Maximum drug plasma concentration (Cmax)., Biomarker evaluation: Changes in levels of total, unconjugated and conjugated bilirubin in blood, from baseline (i.e., prior first dose of SCO-101), at each cycle, and until end of treatment; and correlation between patient tolerability and pharmacokinetic parameters for SCO-101 and FOLFIRI components. / Selected UGT1A1 polymorphism (from a pre-treatment blood sample).

Source: https://euclinicaltrials.eu/ctis-public/view/2024-518877-33-00